EU clinical trial 2023-505218-68-00: C4531002-A Phase 2, Randomized, Double-Blind, Placebo-Controlled Study to Investigate the Efficacy and Safety of PF-07275315 and PF-07264660 in Adult Participants with Moderate-Severe Atopic Dermatitis.
Protocol code: C4531002
Sponsor: Pfizer Inc. (Pharmaceutical company). Phase: Therapeutic exploratory (Phase II). Countries: Poland (ongoing, recruitment ended), Germany (ongoing, recruitment ended).
Therapeutic area(s): Diseases [C] - Skin and Connective Tissue Diseases [C17]
Gender: Female, Male. Age: 18-64 years, 65+ years. Enrolment: 70.
Status: Ongoing, recruitment ended. Start date (EU): 2025-06-12. Decision date: 2024-08-09. Results received: No. Last updated: 2026-06-03.
Decision dates by country: DE: 2024-08-12, PL: 2024-08-09

Condition(s): Moderate-Severe Atopic Dermatitis

Primary endpoint: "EASI75 (≥75% improvement from baseline) at Week 16"
Endpoint(s): "vIGA score of clear (0) or almost clear (1) (on a 5-point scale) and a reduction from baseline of ≥2 points at all scheduled time points", "EASI75 (≥75% improvement from baseline) at scheduled time points except Week 16", "Percent change from baseline in EASI total score at scheduled time points", "Incidence of treatment emergent AEs, clinically significant changes in vital signs, electrocardiogram (ECG), and laboratory tests"

Source: https://euclinicaltrials.eu/ctis-public/view/2023-505218-68-00